EU clinical trial 2024-519298-21-00: A Phase 3, Multicenter, Randomized, Double-Blind, Placebo-Controlled Study to Assess Efficacy and Safety of REGN7508, a Monoclonal Antibody Against FXI, for Primary Prophylaxis of Cancer-Associated Thrombosis for Participants with Solid Tumors Undergoing Cancer Treatment (ROXI-CAT-I)
Protocol code: R7508-CAT-2392
Sponsor: Regeneron Pharmaceuticals Inc. (Pharmaceutical company). Phase: Therapeutic confirmatory (Phase III). Countries: Belgium (authorised, recruitment pending), Czechia (ended), France (authorised, recruitment pending), Romania (authorised, recruitment pending), Germany (authorised, recruitment pending), Poland (authorised, recruitment pending), Bulgaria (authorised, recruitment pending), Spain (authorised, recruitment pending).
Therapeutic area(s): Diseases [C] - Hemic and Lymphatic Diseases [C15]; Diseases [C] - Cardiovascular Diseases [C14]
Gender: Female, Male. Age: 18-64 years, 65+ years. Enrolment: 324.
Decision date: 2026-04-27. Results received: No. Last updated: 2026-05-06.
Decision dates by country: BG: 2026-05-04, DE: 2026-04-29, CZ: 2026-04-28, BE: 2026-04-27, FR: 2026-05-04, RO: 2026-05-04, PL: 2026-04-30, ES: 2026-05-06

Condition(s): Cancer-Associated Thrombosis (CAT).
Product: Placebo matching REGN7508, REGN7508

Primary endpoint: Time-to-first event of centrally adjudicated VTE [Deep Vein Thrombosis (DVT), non-fatal Pulmonary Embolism (PE) or Arterial thromboembolism (ATE), or thromboembolism- or ATE-related death], Time-to-first event of centrally adjudicated International Society of Thrombosis and Hemostasis (ISTH) major bleeding or Clinically Relevant Non-Major (CRNM) bleeding
Endpoint(s): Time-to-first event of DVT (symptomatic or asymptomatic [proximal])., Time-to-first event of non-fatal PE (symptomatic or asymptomatic)., Time-to-first event of any ATE., Time-to-first event of thromboembolism- or ATE-related death, Occurrence of Treatment-Emergent Adverse Events (TEAEs), Severity of TEAEs, Incidence of Anti-Drug Antibody (ADA) to REGN7508, Magnitude of ADA to REGN7508

Source: https://euclinicaltrials.eu/ctis-public/view/2024-519298-21-00